EU clinical trial 2025-521039-35-00: Impact on delirium of the use of DEXmedetomidine as first-line sedation in PEDIAtric intensive care: the PEDIADEX randomized controlled trial
Protocol code: PEDIADEX
Sponsor: Centre Hospitalier Regional Universitaire De Tours (Hospital/Clinic/Other health care facility). Phase: Therapeutic confirmatory (Phase III). Countries: France (authorised, recruitment pending).
Therapeutic area(s): Analytical, Diagnostic and Therapeutic Techniques and Equipment [E] - Anesthesia and Analgesia [E03]; Analytical,Diagnostic,Therapeutic Techniques and Equipment [E]-Surgical Procedures, Operative [E04]
Gender: Female, Male. Age: 0-17 years. Enrolment: 266.
Status: Authorised, recruitment pending. Decision date: 2025-10-29. Results received: No. Last updated: 2025-10-29.

Condition(s): Impact on delirium of the use of DEXmedetomidine as first-line sedation in PEDIAtric intensive care:
Product: Dexmedetomidine 100 micrograms/ml concentrate for solution for infusion, Midazolam Lek 1 mg/ml raztopina za injiciranje/infundiranje

Primary endpoint: The proportion of children with at least one episode of delirium during the pediatric intensive care stay, measured with CAPD scale. Delirium will be defined as CAPD higher or equal to 9.
Endpoint(s): The percentage of sedation scores in the target sedation range evaluated with COMFORT B scale every 4 hours, in each group, Percentage of under-sedation, and adverse events (such as unplanned extubation with reintubation, accidental removal of a central line), Percentage of over-sedation, The daily cumulative weight-adjusted dose of IV sedative agents (benzodiazepine, ketamine, propofol) and opioids required in each group., Number of days exposed to sedatives and opioids, The incidence of iatrogenic withdrawal syndrome, The number of days with CAPD score higher than or equal to 9, The severity of delirium defined by the need for antipsychotic drugs, Hypotension/ bradycardia, needing an intervention, unplanned extubation, accidental removal of a central line, The mechanical ventilation time in hours, Need for re-intubation post extubation, Percentage of brain imaging , electroencephalogramm, Intensive care unit length of stay, in days, Hospital length of stay out of the intensive care unit, in days, In-hospital mortality, The incidence of iatrogenic withdrawal syndrome, Difference in the costs of sedative, analgesics and opioids consumed during the paediatric intensive care stay and valued from the hospital perspective;, Difference in the cost of inpatient stays and the cost of stays in intensive care units valued from the healthcare system perspective, over a three month time horizon.

Source: https://euclinicaltrials.eu/ctis-public/view/2025-521039-35-00